EU clinical trial 2023-505894-33-00: A RANDOMIZED, PHASE 2, DOUBLE-BLIND STUDY TO EVALUATE THE EFFICACY OF DOSTARLIMAB PLUS CHEMOTHERAPY VERSUS PEMBROLIZUMAB PLUS CHEMOTHERAPY IN METASTATIC NON-SQUAMOUS NON-SMALL CELL LUNG CANCER
Protocol code: 213403
Sponsor: Glaxosmithkline Research & Development Limited (Pharmaceutical company). Phase: Therapeutic exploratory (Phase II). Countries: Germany (ended), Romania (ended), Italy (ended), France (ended), Spain (ended), Poland (ended).
Therapeutic area(s): Diseases [C] - Neoplasms [C04]
Gender: Female, Male. Age: 18-64 years, 65+ years. Enrolment: 114.
Status: Ended. Start date (EU): 2020-11-25. End date (EU): 2024-09-10. Decision date: 2024-02-16. Results received: Yes. Last updated: 2024-02-29.
Decision dates by country: FR: 2024-02-16, DE: 2024-02-20, IT: 2024-02-16, RO: 2024-02-19, ES: 2024-02-16, PL: 2024-02-29

Condition(s): Lung Cancer, Non-Small Cell
Product: Pemetrexed Pfizer 25 mg/ml concentrate for solution for infusion., KEYTRUDA 25 mg/mL concentrate for solution for infusion, Carboplatin-Teva 10 mg/ml Concentrate for Solution for Infusion, Cisplatin 1 mg/ml Concentrate for Solution for Infusion, Pemetrexed Pfizer 100 mg powder for concentrate for solution for infusion, JEMPERLI 500 mg concentrate for solution for infusion, Pemetrexed Pfizer 25 mg/ml concentrate for solution for infusion., Pemetrexed Pfizer 25 mg/ml concentrate for solution for infusion.

Primary endpoint: The primary efficacy endpoint ORR will be valuated by RECIST v1.1 based on BICR and will be defined as the proportion of participants with BOR of CR or PR in the analysis population.
Endpoint(s): - OS will be defined as the time from the date of randomization to the date of death by any cause. - PFS will be evaluated using RECIST v1.1 based on Investigator assessment and will be defined as the time from the date of randomization to the date of PD or death by any cause, whichever occurs first., Assess the incidence of TEAEs, SAEs, irAEs, TEAEs leading to death, and AEs leading to discontinuation occurring while participants are on treatment or up to 90 days after the last dose of study treatment. Clinical laboratory parameters (hematology, chemistry, thyroid function, urinalysis), vital signs, ECOG performance status, ECG parameters, physical examinations, and usage of concomitant medications will be collected.

Source: https://euclinicaltrials.eu/ctis-public/view/2023-505894-33-00